EU clinical trial 2024-515331-30-00: Loc-R01: Randomized Phase IB/II Study of escalating doses of Lenalidomide and Ibrutinib in association with R-MPV as a targeted induction treatment for patients aged 18 to 60 (up to 65 for phase II) with a newly diagnosed Primary Central Nervous System Lymphoma
Protocol code: IC 2019-02
Sponsor: Institut Curie (Hospital/Clinic/Other health care facility). Phase: Phase I and Phase II (Integrated)- First administration to humans. Countries: France (ongoing, recruitment ended).
Therapeutic area(s): Diseases [C] - Hemic and Lymphatic Diseases [C15]; Diseases [C] - Neoplasms [C04]
Gender: Female, Male. Age: 18-64 years. Enrolment: 118.
Status: Ongoing, recruitment ended. Start date (EU): 2020-10-30. Decision date: 2024-10-29. Results received: No. Last updated: 2026-03-23.

Condition(s): Primary Central Nervous System Lymphoma (PCNSL)

Source: https://euclinicaltrials.eu/ctis-public/view/2024-515331-30-00